EU clinical trial 2023-504809-37-00: A Phase 3, Multi-center, Randomized, Double-blind Trial to Evaluate the Efficacy and Safety of Aficamten Compared to Metoprolol in Adults with Symptomatic Obstructive Hypertrophic Cardiomyopathy
Protocol code: CY 6032
Sponsor: Cytokinetics Inc. (Pharmaceutical company). Phase: Therapeutic confirmatory (Phase III). Countries: Denmark (ended), Italy (ended), Hungary (ended), Germany (ended), Spain (ended), Netherlands (ended), France (ended).
Therapeutic area(s): Diseases [C] - Congenital, Hereditary, and Neonatal Diseases and Abnormalities [C16]
Gender: Female, Male. Age: 18-64 years, 65+ years. Enrolment: 53.
Status: Ended. Start date (EU): 2024-02-07. End date (EU): 2025-02-14. End date: 2025-03-28. Decision date: 2023-12-11. Results received: Yes. Last updated: 2025-02-14.
Decision dates by country: DE: 2023-12-12, ES: 2023-12-13, DK: 2023-12-11, HU: 2023-12-11, NL: 2023-12-18, FR: 2023-12-12, IT: 2023-12-13

Condition(s): Symptomatic Obstructive Hypertrophic Cardiomyopathy
Product: Placebo (Metoprolol succinate), Metoprololsuccinat STADA® 47,5 mg Retardtabletten, Aficamten, DOBUTAMINE, Placebo (Aficamten)

Primary endpoint: Change in peak oxygen uptake (pVO2) by cardiopulmonary exercise testing (CPET) from baseline to Week 24
Endpoint(s): Proportion of participants with ≥ 1 class improvement in NYHA Functional Class from baseline to Week 24, Change in Kansas City Cardiomyopathy Questionnaire – Clinical Summary Score (KCCQ-CSS) from baseline to Week 24, "• Change in left ventricular mass index (LVMI) from baseline to Week 24 • Change in left atrial volume index (LAVI) from baseline to Week 24", Change from baseline values in NT-proBNP from baseline to Week 24, Change in post-Valsalva LVOT-G from baseline to Week 24

Source: https://euclinicaltrials.eu/ctis-public/view/2023-504809-37-00